EU clinical trial 2026-525707-27-00: Study to assess the plasma concentration of rilzabrutinib given as a tablet to adult participants with severe renal impairment compared to matched participants with normal renal function
Protocol code: POP22852
Sponsor: Sanofi-Aventis Recherche & Developpement (Pharmaceutical company). Phase: Human Pharmacology (Phase I)- Other. Countries: Germany (authorised, recruitment pending).
Therapeutic area(s): Diseases [C] - Immune System Diseases [C20]
Gender: Female, Male. Age: 18-64 years, 65+ years. Enrolment: 8.
Status: Authorised, recruitment pending. Decision date: 2026-07-30. Results received: No. Last updated: 2026-07-30.

Condition(s): Renal Impairment

Source: https://euclinicaltrials.eu/ctis-public/view/2026-525707-27-00